EU clinical trial 2024-512123-37-00: 58-week Open-Label Trial of Tavapadon in Parkinson’s Disease (Tempo-4 Trial)
Protocol code: CVL-751-PD-004
Sponsor: Cerevel Therapeutics LLC (Pharmaceutical company). Phase: Therapeutic confirmatory (Phase III). Countries: France (ended), Germany (ended), Italy (ended), Spain (ended), Czechia (ended), Hungary (ended), Bulgaria (ended), Poland (ended).
Therapeutic area(s): Diseases [C] - Nervous System Diseases [C10]
Gender: Female, Male. Age: 18-64 years, 65+ years. Enrolment: 487.
Status: Ended. Start date (EU): 2021-05-27. End date (EU): 2025-12-01. End date: 2025-12-02. Decision date: 2024-06-19. Results received: No. Last updated: 2025-11-26.
Decision dates by country: BG: 2024-06-19, CZ: 2024-06-20, ES: 2024-07-17, DE: 2024-06-21, IT: 2024-07-17, FR: 2024-07-02, HU: 2024-06-19, PL: 2024-07-17

Condition(s): Parkinson's disease
Product: Tavapadon, Tavapadon, Tavapadon

Primary endpoint: To Evaluate the safety and tolerability of long-term administration of tavapadon in subjects with PD: •Nature, frequency, and temporality of TEAEs (nonserious and serious), including abuse related AEs and AEs related to MHIs •Frequency of discontinuations •QUIP RS •ESS •C-SSRS •SMWQ •Clinical laboratory evaluations •Vital signs •Physical and neurological examinations •ECGs
Endpoint(s): To Evaluate the effects of tavapadon on PD symptoms during long-term treatment • Change from baseline in the MDS-UPDRS Parts I, II, and III scores • Change from baseline in the Hauser diary (only in subjects who require daily L-Dopa or equivalent therapy for symptom control at the time of enrollment) • Change from baseline in the EQ-5D-5L index and VAS scores, To evaluate the effects of tavapadon on L-Dopa usage: •Change from baseline in L-Dopa usage, To Evaluate speech and facial expression characteristics of subjects with PD: •Exploratory analyses of audio and video data collected from subject administered remote digital testing of speech and facial expressions through an interactive application platform on the subject's personal mobile device may be conducted

Source: https://euclinicaltrials.eu/ctis-public/view/2024-512123-37-00